EU clinical trial 2024-518350-17-00: Evaluation of the clinical implementation of biofilm susceptibility to antibiotics using Minimum Biofilm Eradication Concentration (MBEC) in addition to Minimum Inhibitory Concentration (MIC) to guide the treatment of periprosthetic joint infections; a prospective randomized clinical trial
Sponsor: Vaestra Goetalandsregionen (Hospital/Clinic/Other health care facility). Phase: Therapeutic use (Phase IV). Countries: Sweden (authorised, recruitment pending).
Therapeutic area(s): Diseases [C] - Musculoskeletal Diseases [C05]
Gender: Female, Male. Age: 18-64 years, 65+ years. Enrolment: 64.
Status: Authorised, recruitment pending. Decision date: 2024-10-23. Results received: No. Last updated: 2024-10-23.

Condition(s): Periprosthetic hip joint infection Periprosthetic knee joint infection
Product: LINEZOLID, FUSIDIC ACID, RIFAMPICIN, LEVOFLOXACIN, SULFAMETHOXAZOLE AND TRIMETHOPRIM, CLINDAMYCIN

Primary endpoint: Proportions of antimicrobial regimens other than 1st-line treatment that will be administered after the guidance of MIC-testing versus MIC- and MBEC-testing combined. [6 weeks]
Endpoint(s): Repeat procedure, relapse or reinfection [12 months], Oxford Hip Score/Oxford Knee Score [12 months], EQ-5D: Generic health status patient-reported outcome measure [12 months], Time to revision [12 months], Inpatient care: Resource consumption measure (days) [Up to 12 months], Outpatient visits: Resource consumption measure, number of visits, type of visits [Up to 12 months], Discharge destination: Resource consumption measure [Up to 12 months], Heath care costs: Compound measure using data from outcome 6-8 (currency EUR) [Time Frame: Up to 12 months], Development of additional antimicrobial resistance of the relapse causative strain [12 months], Correlation between the virulence properties of the causative bacteria and patient outcome (infection resolution versus recurrent infection) [12 months]

Source: https://euclinicaltrials.eu/ctis-public/view/2024-518350-17-00